EU clinical trial 2023-508305-24-00: Safety, Tolerability, Pharmacokinetics, and Pharmacodynamics of NBI-1076986 in Healthy Adults.
Protocol code: NBI-1076986-1761
Sponsor: Neurocrine Biosciences Inc. (Pharmaceutical company). Phase: Human Pharmacology (Phase I)- First administration to humans. Countries: Netherlands (ongoing, recruiting).
Therapeutic area(s): Diseases [C] - Nervous System Diseases [C10]
Gender: Female, Male. Age: 18-64 years, 65+ years. Enrolment: 130.
Status: Ongoing, recruiting. Start date (EU): 2024-03-29. Decision date: 2024-02-16. Results received: No. Last updated: 2025-12-19.

Condition(s): Movement disorders

Source: https://euclinicaltrials.eu/ctis-public/view/2023-508305-24-00